EU clinical trial 2023-509020-17-00: A Phase 1, randomized, double blind, single center, placebo controlled, single escalating weight-adjusted dose, safety study of HI-6 dimethyl sulfonate (HI-6 DMS) administered by iv bolus and infusion in healthy volunteers
Protocol code: HI-6
Sponsor: Direction Centrale Du Service De Sante Des Armees (Hospital/Clinic/Other health care facility). Phase: Human Pharmacology (Phase I)- First administration to humans. Countries: France (ended).
Therapeutic area(s): Phenomena and Processes [G] - Musculoskeletal and Neural Physiological Phenomena [G11]; Diseases [C] - Disorders of Environmental Origin [C21]; Diseases [C] - Pathological Conditions, Signs and Symptoms [C23]
Gender: Female, Male. Age: 18-64 years. Enrolment: 36.
Status: Ended. Start date (EU): 2024-11-25. End date (EU): 2025-04-24. Decision date: 2023-12-20. Results received: No. Last updated: 2025-04-10.

Condition(s): Treatment of patients poisoned with organophosphorus compounds

Source: https://euclinicaltrials.eu/ctis-public/view/2023-509020-17-00